EU clinical trial 2023-505522-34-00: The effect of multiple oral doses of BI 1015550 on the pharmacokinetics of nintedanib and pirfenidone administered single dose to healthy male subjects (open-label, two-period, fixed-sequence crossover trial)
Protocol code: 1305-0034
Sponsor: Boehringer Ingelheim International GmbH (Pharmaceutical company). Phase: Human Pharmacology (Phase I)- Other. Countries: Germany (ended).
Therapeutic area(s): Not possible to specify
Gender: Male. Age: 18-64 years. Enrolment: 14.
Status: Ended. Start date (EU): 2023-11-08. End date (EU): 2023-12-14. Decision date: 2023-09-22. Results received: Yes. Last updated: 2023-09-22.

Condition(s): Healthy volunteer trial
Product: Esbriet 267 mg film-coated tablets, BI 1015550, Ofev 100 mg soft capsules

Primary endpoint: for nintedanib: AUC0-tz (area under the concentration-time curve of the analyte in plasma over the time interval from 0 to the last quantifiable data point), for nintedanib: Cmax (maximum measured concentration of the analyte in plasma), for nintedanib: AUC0-∞ (area under the concentration-time curve of the analyte in plasma over the time interval from 0 extrapolated to infinity), for pirfenidone: AUC0-tz (area under the concentration-time curve of the analyte in plasma over the time interval from 0 to the last quantifiable data point), for pirfenidone: Cmax (maximum measured concentration of the analyte in plasma), for pirfenidone: AUC0-∞ (area under the concentration-time curve of the analyte in plasma over the time interval from 0 extrapolated to infinity)

Source: https://euclinicaltrials.eu/ctis-public/view/2023-505522-34-00